EU clinical trial 2024-514066-40-00: A single arm phase II study evaluating intracranial efficacy of Sacituzumab govitecan (SG) with bevacizumab in patients with asymptomatic brain metastases from non-small cell lung cancer (NSCLC)
Protocol code: CO-NL-979-6888
Sponsor: Academisch Ziekenhuis Maastricht (Hospital/Clinic/Other health care facility). Phase: Therapeutic exploratory (Phase II). Countries: Netherlands (ongoing, recruiting).
Therapeutic area(s): Diseases [C] - Respiratory Tract Diseases [C08]; Diseases [C] - Neoplasms [C04]
Gender: Female, Male. Age: 18-64 years, 65+ years. Enrolment: 25.
Status: Ongoing, recruiting. Start date (EU): 2025-07-10. Decision date: 2025-01-21. Results received: No. Last updated: 2026-02-09.

Condition(s): Patients with metastatic non-squamous NSCLC pre-treated with platinum-doublet chemotherapy and ICI (for those with targetable oncogenic drivers, pretreated with at least one tyrosine kinase inhibitor and platinum-doublet chemotherapy), and active BM, defined as asymptomatic untreated or unequivocally progressive after local treatment
Product: Trodelvy 200 mg powder for concentrate for solution for infusion, VEGZELMA 25 mg/mL concentrate for solution for infusion, VEGZELMA 25 mg/mL concentrate for solution for infusion

Primary endpoint: BM ORR (RANO-BM). This will be evaluated with MRI brain after six weeks of treatment and thereafter every six weeks. Confirmed BM ORR according to RANO-BM will be measured at 12 weeks.
Endpoint(s): All imaging related endpoints will be measured with MRI brain for BM related outcomes and CT chest and upper abdomen for extracranial related outcomes after six weeks of treatment and thereafter every six weeks, BM ORR (RANO-BM), with additional criteria for potential pseudo response due to bevacizumab, BM DCR (RANO-BM), median CNS PFS (RANO-BM), Extracranial ORR and DCR (RECIST 1.1)., Median extracranial PFS (based on RECIST 1.1), Median overall PFS (based on RANO-BM for BM and RECIST 1.1 for extracranial lesions), Median OS, Safety, evaluated with CTCAE v5.0 criteria during every visit

Source: https://euclinicaltrials.eu/ctis-public/view/2024-514066-40-00